EU clinical trial 2026-525211-14-00: Curing HIV: proof of concept randomized clinical trial with Pyrimethamine, Lenalidomide, TOpiramate (PLUTO)
Protocol code: 2026-525211-14-00
Sponsor: Erasmus Universitair Medisch Centrum Rotterdam (Erasmus MC) (Hospital/Clinic/Other health care facility). Phase: Therapeutic exploratory (Phase II). Countries: Netherlands (ongoing, recruiting).
Therapeutic area(s): Diseases [C] - Virus Diseases [C02]
Gender: Female, Male. Age: 18-64 years, 65+ years. Enrolment: 30.
Status: Ongoing, recruiting. Start date (EU): 2026-07-15. Decision date: 2026-04-24. Results received: No. Last updated: 2026-06-08.

Condition(s): HIV-1
Product: PYRIMETHAMINE, TOPIRAMATE, LENALIDOMIDE

Primary endpoint: Phase I : Fold change in cell-associated HIV-RNA at time points 6 (T=6) and 24 hours (T=24) after LRA treatment compared to baseline (T=0) before treatment. Phase II: Log transformed HIV-DNA at T=4 weeks compared to T=0.
Endpoint(s): Key secondary endpoint Phase I and phase II: The number and severity of clinical and biochemical adverse events using CTCAEv6.0., Phase I: Quantitative and qualitative patient reported outcomes of treatment satisfaction, QoL and stigma by validated questionnaires at T=0, T=24hr and T=7 days and by a semi-structured interview before the intervention and at T=24hr., Phase I: Change in plasma HIV-RNA between and within arms at T=6hr, T=24hr and T = 7 days compared to T=0., Phase I: The change of the frequency, functionality and phenotype of immune cell subpopulations; total T cells and HIV specific CD4+ and CD8+ T cells, B-cell differentiation, HIV specific B-cell clonotype and immunoglobulin sequence, and HIV specific antibody function, between and within the groups at T=7 days, compared to T=0., Phase I: Drug plasma levels of LRA compounds at T=0h, T= 6hr, T=24hr and T=7 days., Phase I: Drug plasma levels of ART at T=0hr, T=6hr, T=24hr and T=7 days., Phase I: The correlation between ex vivo and in vivo fold change in cell-associated HIV-RNA from T=0 to T=24hr., Phase II: Quantitative and qualitative patient reported outcomes of treatment satisfaction, QoL and stigma by questionnaires and by a semi-structured interview at T=0 to T=4 weeks., Phase II: Fold change cell associated HIV RNA from T=0 to T=24hr in participants in phase 2 com-pared to T=0 to T=24hr in participants in phase 1 overall and by prior LRA exposure., Phase II: Change in plasma HIV-RNA absolute copies/mL and proportion with viral target detectable, >30, >50, and >200 c/mL within group at T=24hr, T=1, 2, 3, and 4 weeks compared to T=0., Phase II: The change of the frequency, functionality and phenotype of immune cell subpopulations; total T cells and HIV specific CD4+ and CD8+ T cells, B-cell differentiation, HIV specific B-cell clonotype and immunoglobulin sequence, and HIV specific antibody function, at T=1 and T=4 weeks compared to T=0., Phase II: Drug plasma levels of LRA compounds at T=1, 2, 3, and 4 weeks., Phase II: Drug plasma of ART levels T=1, 2, 3, and 4 weeks., Phase II: The correlation between ex vivo and in vivo fold change in cell-associated HIV-RNA from T=0 to T=24hr overall and by prior LRA exposure.

Source: https://euclinicaltrials.eu/ctis-public/view/2026-525211-14-00